EU clinical trial 2023-503185-23-00: MULTICENTRE, RANDOMISED, DOUBLE-BLIND, VEHICLE AND ACTIVE-CONTROLLED PHASE III STUDY EVALUATING THE EFFICACY AND SAFETY OF KETOTIFEN OPHTHALMIC SOLUTION 0.5 MG/ML COMPARED TO VEHICLE AND KETOFTIL (KETOTIFEN OPHTHALMIC SOLUTION 0.5 MG/ML) FOR THE TREATMENT OF SEASONAL ALLERGIC CONJUNCTIVITIS.
Protocol code: KET-001
Sponsor: Genetic S.p.A. (Pharmaceutical company). Phase: Therapeutic confirmatory (Phase III). Countries: Italy (ended).
Therapeutic area(s): Diseases [C] - Eye Diseases [C11]
Gender: Female, Male. Age: 18-64 years, 65+ years. Enrolment: 253.
Status: Ended. Start date (EU): 2023-05-31. End date (EU): 2024-10-21. Decision date: 2023-05-05. Results received: Yes. Last updated: 2025-02-11.

Condition(s): SEASONAL ALLERGIC CONJUNCTIVITIS
Product: Placebo (Glycerol, Hydrochloric Acid, Water for injections), KETOFTIL 0,5 mg/ml collirio,soluzione, KETOTIFEN 0.5 MG/ML

Primary endpoint: To evaluate Ocular Itching between V1 (baseline) and V5 (14 days) later Ketotifen/ Ketoftil®/Placebo administrations. Ocular itching scores will be self-assessed by the participants using a 5-point scale.
Endpoint(s): To evaluate Conjunctival Redness at 30 minutes, 2 days, 7 days, 14 days later the first Ketotifen/Ketoftil®/Placebo administrations. Conjunctival redness will be assessed by the Investigator using the Efron scale., To evaluate tearing and eyelid swelling at 30 minutes, 2 days, 7 days, 14 days later the first Ketotifen/Ketoftil®/Placebo administrations. Tearing and eye swelling will be assessed by the Investigator using a 4-point scale, To evaluate conjunctival chemosis at 30 minutes, 2 days, 7 days, 14 days later the first Ketotifen/Ketoftil®/Placebo administrations. Conjunctival chemosis will be assessed by the Investigator using a 3-point scale., To evaluate the product tolerability at 30 minutes, 2 days, 7 days, 14 days later the first Ketotifen/Ketoftil®/Placebo administrations. Product tolerability will be assessed by the Investigator using the Visual Analog Scale (VAS)., Quantitative and Qualitative Evaluation of Safety in terms of adverse events reported.

Source: https://euclinicaltrials.eu/ctis-public/view/2023-503185-23-00